EU clinical trial 2024-516206-28-00: DT-9081 trial in participants with advanced solid tumours.
Protocol code: DT-9081-CLI-001
Sponsor: Domain Therapeutics (Pharmaceutical company). Phase: Human Pharmacology (Phase I)- First administration to humans. Countries: France (ended), Belgium (ended).
Therapeutic area(s): Diseases [C] - Neoplasms [C04]
Gender: Female, Male. Age: 18-64 years, 65+ years. Enrolment: 84.
Status: Ended. Start date (EU): 2022-11-17. End date (EU): 2025-04-08. Decision date: 2024-09-05. Results received: No. Last updated: 2024-12-09.
Decision dates by country: BE: 2024-09-06, FR: 2024-09-05

Condition(s): Participants with advanced ( unresectable, recurrent or metastatic) solid tumours

Source: https://euclinicaltrials.eu/ctis-public/view/2024-516206-28-00